EU clinical trial 2024-517878-21-00: ITPP as an adjunctive treatment for progressive respiratory failure in COVID-19 and other pulmonary parenchymal infections - a randomized, double-blind, non-commercial phase II clinical trial [BREATH2]
Protocol code: ABM/COVID19/0034
Sponsor: Wojskowy Instytut Medyczny Panstwowy Instytut Badawczy (Hospital/Clinic/Other health care facility). Phase: Therapeutic exploratory (Phase II). Countries: Poland (ended).
Therapeutic area(s): Diseases [C] - Bacterial Infections and Mycoses [C01]; Diseases [C] - Virus Diseases [C02]
Gender: Female, Male. Age: 18-64 years, 65+ years. Enrolment: 100.
Status: Ended. Start date (EU): 2023-11-28. End date (EU): 2025-06-11. Decision date: 2025-01-11. Results received: Yes. Last updated: 2025-02-10.

Condition(s): COVID-19 and other pulmonary parenchyma infections.
Product: OXY111A, Injectio Natrii Chlorati Isotonica Polpharma, 9 mg/ml, rozpuszczalnik do sporządzania leków parenteralnych

Primary endpoint: Improvement of respiratory capacity in patients who receive ITPP as adjunct therapy, as measured by an improvement in gasometric and biochemical parameters.
Endpoint(s): Determination of the ITPP safety profile and tolerance.

Source: https://euclinicaltrials.eu/ctis-public/view/2024-517878-21-00